EU clinical trial 2025-521283-35-00: Vasopressin and Steroids in addition to Adrenaline in cardiac arrest -a randomized clinical trial
Sponsor: Tiohundra AB (Health care). Phase: Therapeutic confirmatory (Phase III). Countries: Sweden (ongoing, recruitment ended).
Therapeutic area(s): Diseases [C] - Cardiovascular Diseases [C14]
Gender: Female, Male. Age: 18-64 years, 65+ years. Enrolment: 1400.
Status: Ongoing, recruitment ended. Start date (EU): 2026-07-01. Decision date: 2025-04-02. Results received: No. Last updated: 2026-06-22.

Condition(s): Cardiac arrest
Product: Adrenalin Aguettant 0,1 mg/ml, injektionsvätska, lösning i förfylld spruta, Solu-Cortef 100 mg pulver och vätska till injektionsvätska, lösning., Empressin 40 IE/2 ml koncentrat till infusionsvätska, lösning, Solu-Medrol 40 mg pulver och vätska till injektionsvätska, lösning

Primary endpoint: Survival at 30 days

Source: https://euclinicaltrials.eu/ctis-public/view/2025-521283-35-00